EU clinical trial 2023-507933-12-00: A Randomized, Open-label, Phase 3 Trial of Dato-DXd Plus Pembrolizumab vs Pembrolizumab Alone in Treatment-naïve Subjects with Advanced or Metastatic PD-L1 High (TPS ≥50%) Non-small Cell Lung Cancer Without Actionable Genomic Alterations (TROPION-Lung08)
Protocol code: DS1062-A-U304
Sponsor: Daiichi Sankyo Inc. (Pharmaceutical company). Phase: Therapeutic confirmatory (Phase III). Countries: France (ongoing, recruitment ended), Romania (ongoing, recruitment ended), Italy (ongoing, recruitment ended), Greece (ongoing, recruitment ended), Portugal (ongoing, recruitment ended), Netherlands (ongoing, recruitment ended), Poland (ongoing, recruitment ended), Spain (ongoing, recruitment ended), Austria (ongoing, recruitment ended), Germany (ongoing, recruitment ended), Belgium (ongoing, recruitment ended), Hungary (ongoing, recruitment ended).
Therapeutic area(s): Diseases [C] - Neoplasms [C04]
Gender: Female, Male. Age: 18-64 years, 65+ years. Enrolment: 224.
Status: Ongoing, recruitment ended. Start date (EU): 2022-08-18. Decision date: 2024-04-25. Results received: No. Last updated: 2026-05-22.
Decision dates by country: PL: 2024-04-29, PT: 2024-04-29, RO: 2024-04-29, GR: 2024-05-13, FR: 2024-04-25, NL: 2024-04-26, IT: 2024-05-15, AT: 2024-06-04, DE: 2024-04-30, BE: 2024-04-26, ES: 2024-04-29, HU: 2024-04-26

Condition(s): Advanced or Metastatic Non-small Cell Lung Cancer (NSCLC)
Product: KEYTRUDA 25 mg/mL concentrate for solution for infusion, Datopotamab deruxtecan, KEYTRUDA 25 mg/mL concentrate for solution for infusion

Primary endpoint: Progression-free survival (PFS) is defined as the time from randomization to the first documented radiographic disease progression or death due to any cause, whichever occurs first. Overall survival (OS) is defined as the time from randomization to death due to any cause.
Endpoint(s): PFS is defined as the time from randomization to the first documented radiographic disease progression or death due to any cause, whichever occurs first, PFS is defined as the time from randomization to the first documented radiographic disease progression or death due to any cause, whichever occurs first., PFS2 is defined as the time from date of randomization to the first documented disease progression on next-line therapy or death due to any cause, whichever occurs first., ORR is defined as the proportion of subjects who achieved a BOR of confirmed CR or confirmed PR., Duration of response (DoR) is defined as the time from the date of the first documentation of objective response (confirmed CR or confirmed PR) to the date of the first radiographic disease progression or death due to any cause, whichever occurs first., Time to response (TTR) is defined as the time from randomization to the date of the first documentation of objective response (confirmed CR or confirmed PR) in responding subjects., Disease control rate (DCR) is defined as the proportion of subjects who achieved a BOR of confirmed CR, confirmed PR, or stable disease (SD)., Time to deterioration (TTD) is defined as the time from randomization to first onset of a ≥10-point increase in cough, chest pain, or dyspnea, confirmed by a second adjacent ≥10- point increase from randomization in the same symptom, or confirmed by death within 21 days of a ≥10- point increase from randomization., Treatment-emergent adverse events (TEAEs), serious adverse events (SAEs), adverse events of special interest (AESIs), Eastern Cooperative Oncology Group performance status (ECOG PS), vital sign measurements, standard clinical laboratory parameters (hematology, clinical chemistry, and urinalysis), electrocardiogram parameters, echocardiogram (ECHO)/multigated acquisition (MUGA) scan findings, and ophthalmologic findings., Anti-drug antibody (ADA) prevalence: the proportion of subjects who are ADA-positive at any point in time (at baseline or post-baseline) ADA incidence: the proportion of subjects having a treatment-emergent ADA Titer and neutralizing antibodies will be determined when the ADA is positive., OS is defined as the time from randomization to death due to any cause.

Source: https://euclinicaltrials.eu/ctis-public/view/2023-507933-12-00